EU clinical trial 2025-521754-41-00: A Phase 1, Single-Center, Open-Label, Fixed-Sequence, 2-Part Study to Assess the Pharmacokinetics of IMU-838 Administered Alone and in Combination with Multiple Doses of Gemfibrozil as CYP2C8 Inhibitor, or Rifampicin as CYP2C8 Inducer, in Healthy Subjects
Protocol code: P1-IMU838–DDI-CYP2C8
Sponsor: Immunic AG (Pharmaceutical company). Phase: Human Pharmacology (Phase I)- Other. Countries: Netherlands (ended).
Therapeutic area(s): Diseases [C] - Nervous System Diseases [C10]
Gender: Female, Male. Age: 18-64 years. Enrolment: 24.
Status: Ended. Start date (EU): 2025-08-15. End date (EU): 2026-02-25. Decision date: 2025-07-10. Results received: No. Last updated: 2025-11-10.

Condition(s): Multiple sclerosis

Source: https://euclinicaltrials.eu/ctis-public/view/2025-521754-41-00